EU clinical trial 2025-522575-29-00: Evaluation of the persistency of the preoperative anxiolytic effect of music therapy vs midazolam: electroencephalographic and clinical analysis
Sponsor: Consorci Mar Parc De Salut De Barcelona (Hospital/Clinic/Other health care facility). Phase: Therapeutic use (Phase IV). Countries: Spain (authorised, recruiting).
Therapeutic area(s): Analytical, Diagnostic and Therapeutic Techniques and Equipment [E] - Anesthesia and Analgesia [E03]
Gender: Female, Male. Age: 18-64 years, 65+ years. Enrolment: 100.
Status: Authorised, recruiting. Start date (EU): 2026-04-13. Decision date: 2025-12-05. Results received: No. Last updated: 2025-12-05.

Condition(s): Preoperative anxiety
Product: MIDAZOLAM SERRACLINICS 1 mg/ml SOLUCIÓN INYECTABLE Y PARA PERFUSIÓN EFG

Primary endpoint: Raw electroencephalogram (EEG) collected with Bispectral Index monitoring (BIG). Bilateral BIS sensors allow to get levels of arousal and valencia, Scales to measure anxiety:“Preoperative Anxiety and Information Scale (APAIS), The Hospital Anxiety Depression Scale (HADS) and Visual Analogue anxiety Scale (VAS)
Endpoint(s): Processed EEG (BIS index), blood pressure, heart rate and oxygen saturation, demographics, surgery type (ambulatory vs. admitted patient), adverse effects, chronic use prescriptions

Source: https://euclinicaltrials.eu/ctis-public/view/2025-522575-29-00